EU clinical trial 2025-523482-23-00: PITALC. Pilot study on the effect of PITAC (Pressurized IntraThoracic Aerosol Chemotherapy) by videothoracoscopy in patients with malignant pleural effusion in the light of the results of a retrospective historical cohort treated with talc pleurodesis by videothoracoscopy
Protocol code: 69HCL24_1002
Sponsor: Hospices Civils De Lyon (Hospital/Clinic/Other health care facility). Phase: Therapeutic exploratory (Phase II). Countries: France (authorised, recruitment pending).
Therapeutic area(s): Diseases [C] - Neoplasms [C04]
Gender: Female, Male. Age: 18-64 years, 65+ years. Enrolment: 20.
Status: Authorised, recruitment pending. Decision date: 2026-07-16. Results received: No. Last updated: 2026-07-16.

Condition(s): neoplastic pleural effusion
Product: DOXORUBICINE ARROW 2 mg/ml, solution pour perfusion, CISPLATINE VIATRIS 1 mg/1 ml, solution à diluer pour perfusion

Primary endpoint: the percentage of recurrence of pleural effusion assessed at 1 month by chest X-ray. Recurrence of pleural effusion is defined by a higher ipsilateral pleural effusion at 1 month compared to hospitalization discharge.
Endpoint(s): Percentage of patients for whom PITAC is fully completed, percentage of patients for whom PITAC is partially completed and percentage of patients for whom PITAC is finally not performed., Overall survival, defined as the delay between PITAC and death. Patients alive at the last assessment will be censored. Estimate will be given at 12 months, Adverse events with assessment at each 12-month follow-up period: renal, hepatic or hematological toxicity, lung injury, acute respiratory distress syndrome, prolonged air leak, hemothorax, wound reopening, pulmonary hernia and toxic emphysema. An independent data safety monitoring board (DSMB) will monitor the safety of the study and make recommendations regarding its continuation, Assessment of quality of life using the EORTC QLQ-C30 questionnaire at 1 and 3 months., Assessment of dyspnea using the MMRC scale at 1, 3, 6 and 12 months., Postoperative complications according to Clavien classification at 3 months., Percentage of patients with local disease control according to chest CT scan at 3 months. The local disease progression at 3 months is assessed by pleural effusion (more significant) and/or the appearance or progression of pleural nodules (number or volume) compared to inclusion., Percentage of recurrence of pleural effusion and mean change of maximum diameter of the pleural effusion assessed at 1 month by pleural ultrasound. Recurrence of pleural effusion is defined by a higher ipsilateral pleural effusion at 1 month compared to hospitalization discharge., Ancillary endpoint: Same endpoints as those used for the assessment of the PITAC strategy (see criteria above).

Source: https://euclinicaltrials.eu/ctis-public/view/2025-523482-23-00